EU clinical trial 2024-515472-13-00: Myocarditis Therapy with IL-1 inhibitor (MYTH-1): a double-blind, phase IIa, placebo controlled, randomized clinical trial to evaluate the efficacy and safety of anakinra in addition to standard of care for the treatment of virus-negative myocarditis.
Sponsor: Ospedale San Raffaele S.r.l. (Hospital/Clinic/Other health care facility). Phase: Therapeutic exploratory (Phase II). Countries: Italy (ended).
Therapeutic area(s): Diseases [C] - Cardiovascular Diseases [C14]
Gender: Female, Male. Age: 18-64 years, 65+ years. Enrolment: 32.
Status: Ended. Start date (EU): 2021-09-23. End date (EU): 2026-02-18. Decision date: 2024-10-16. Results received: No. Last updated: 2024-10-16.

Condition(s): endomyocardial biopsy (EBM)-proven virus-negative myocarditis
Product: ANAKINRA

Primary endpoint: To evaluate the benefit of Anakinra combined with standard immunosuppressive therapy in improving Left Ventricular Ejection Fraction (LVEF) assessed by Trans Thoracic Echocardiograhy (TTE) at 2 months.

Source: https://euclinicaltrials.eu/ctis-public/view/2024-515472-13-00